EU clinical trial 2024-513992-42-00: A multicenter, randomized, open-label, blinded endpoint evaluation, phase 3 study comparing the effect of abelacimab relative to dalteparin on venous thromboembolism (VTE) recurrence and bleeding in patients with gastrointestinal (GI)/genitourinary (GU) cancer associated VTE (Magnolia)
Protocol code: ANT-008
Sponsor: Anthos Therapeutics Inc. (Pharmaceutical company). Phase: Phase II and Phase III (Integrated). Countries: Norway (ended), France (ended), Hungary (ended), Spain (ended), Germany (ended), Netherlands (ended), Sweden (ended), Latvia (ended), Czechia (ended), Austria (ended), Italy (ended), Ireland (ended).
Therapeutic area(s): Diseases [C] - Cardiovascular Diseases [C14]
Gender: Female, Male. Age: 18-64 years, 65+ years. Enrolment: 677.
Status: Ended. Start date (EU): 2022-09-13. End date (EU): 2026-04-06. End date: 2026-04-11. Decision date: 2024-07-29. Results received: No. Last updated: 2026-04-20.
Decision dates by country: NO: 2024-07-30, ES: 2024-07-30, SE: 2024-07-30, AT: 2024-08-05, HU: 2024-07-31, CZ: 2024-08-01, LV: 2024-07-29, IE: 2024-07-29, DE: 2024-08-01, NL: 2024-07-29, IT: 2024-08-05, FR: 2024-07-31

Condition(s): venous thromboembolism (VTE) in patients with gastrointestinal/genitourinary cancer
Product: Fragmin® 5000 IU, Abelacimab 150 mg/ml solution for infusion

Primary endpoint: Time to first event of centrally adjudicated VTE recurrence 6 months post randomization

Source: https://euclinicaltrials.eu/ctis-public/view/2024-513992-42-00